EU clinical trial 2023-509175-16-00: A global phase 3, randomised, double-blind and placebo-controlled study evaluating the efficacy and safety of etavopivat in adolescents and adults with sickle cell disease
Protocol code: NN7535-7807
Sponsor: Novo Nordisk A/S (Pharmaceutical company). Phase: Therapeutic confirmatory (Phase III). Countries: France (ongoing, recruiting), Italy (ongoing, recruiting), Netherlands (ongoing, recruiting), Belgium (ongoing, recruiting), Greece (ongoing, recruiting), Spain (ongoing, recruiting).
Therapeutic area(s): Diseases [C] - Congenital, Hereditary, and Neonatal Diseases and Abnormalities [C16]
Gender: Female, Male. Age: 0-17 years, 18-64 years, 65+ years. Enrolment: 75.
Status: Ongoing, recruiting. Start date (EU): 2025-10-14. Decision date: 2025-03-18. Results received: No. Last updated: 2026-08-06.
Decision dates by country: BE: 2025-03-18, IT: 2025-03-19, NL: 2025-03-18, GR: 2025-03-19, FR: 2025-03-20, ES: 2025-03-20

Condition(s): Sickle cell disease
Product: Placebo, Etavopivat A 200 mg

Primary endpoint: Number of adjudicated VOC events with a medical contact.
Endpoint(s): Change in Hb >1 g/dL (yes/no), Time to onset of first adjudicated VOC., Change in standardised T-score on the PROMIS Fatigue 7a Scale., Change in haemoglobin (Hb), Change in lactate dehydrogenase (LDH), Change in absolute reticulocyte count, Change in indirect bilirubin, Change in distance travelled during the 6-minute walking test (6MWT), Participants achieving the threshold for clinically meaningful change (yes/no) in PROMIS fatigue scale 7a, Participants achieving the threshold for clinically meaningful change (yes/no) in 6MWT

Source: https://euclinicaltrials.eu/ctis-public/view/2023-509175-16-00